EU clinical trial 2023-505985-28-01: An Exploratory, Multi-Centre, Interventional, Prospective, Randomised, Double-Blind, Placebo-Controlled Clinical Trial to Assess the Safety and Efficacy of AON-D21 in Patients with Severe Community-Acquired Pneumonia.
Protocol code: S-D21-C300
Sponsor: Aptarion Biotech AG (Pharmaceutical company). Phase: Therapeutic exploratory (Phase II). Countries: Belgium (ended), France (ended), Germany (ended), Spain (ended).
Therapeutic area(s): Diseases [C] - Respiratory Tract Diseases [C08]
Gender: Female, Male. Age: 18-64 years, 65+ years. Enrolment: 130.
Status: Ended. Start date (EU): 2024-03-04. End date (EU): 2026-03-16. Decision date: 2024-02-13. Results received: No. Last updated: 2025-02-19.
Decision dates by country: BE: 2024-02-23, ES: 2024-03-21, DE: 2024-02-15, FR: 2024-02-13

Condition(s): Severe Community-Acquired Pneumonia
Product: AON-D21, Aon-d21 placebo (5% glucose solution for infusion)

Primary endpoint: Frequency, severity, and relatedness to study drug of serious and non-serious treatment-emergent adverse events until Day 28.
Endpoint(s): Time to no longer requiring respiratory support (defined as High Flow Oxygen ≥ 30 L/min with FiO2 ≥ 30%, Non-Invasive Mechanical Ventilation, Invasive Mechanical Ventilation or Extracorporeal Membrane Oxygenation) within 28 days., Time to no longer requiring any organ support within 28 days., Time to improvement (defined as a de-escalation in respiratory support; no oxygen support/other lower degree oxygen support < High Flow Oxygen ≥ 30 L/min with FiO2 ≥ 30% < Non-Invasive Mechanical Ventilation < Invasive Mechanical Ventilation < Extracorporeal Membrane Oxygenation) within 28 days., Mean change in S/F ratio from Day 1 (Baseline) to Day 7., Organ support-free days until Day 28., Invasive Mechanical Ventilation or Extracorporeal Membrane Oxygenation free days until Day 28., Respiratory support-free days until Day 28., All-cause mortality up to Days 28 and 60., Area under the concentration-time curve (AUC) over the dosing interval at steady state (AUC0-tau), maximum concentration at steady state (Cmax), average drug concentration at steady state (Cav), trough concentrations (Ctrough), time of maximum concentration at steady state (tmax), terminal half-life at steady state (t1/2), accumulation ratios for Cmax and AUC, clearance (CL) and volume of distribution (Vz) of AON-D21 in plasma. From a subset of ≥ 20 participants from selected sites., Determination of C5a inhibitory activity. From a subset of ≥ 100 participants.

Source: https://euclinicaltrials.eu/ctis-public/view/2023-505985-28-01